EU clinical trial 2023-507454-33-00: Study on the investigational drug IAMA-6, placebo-controlled, administered to healthy adult volunteers, at single oral doses and at multiple ascending oral doses to evaluate the safety, tolerability, pharmacokinetics, pharmacodynamics of IAMA-6 and its interaction with food
Protocol code: ECS_IAMA23_0101
Sponsor: Iama Therapeutics S.r.l. (Pharmaceutical company). Phase: Human Pharmacology (Phase I)- First administration to humans. Countries: Italy (ended).
Therapeutic area(s): Diseases [C] - Nervous System Diseases [C10]
Gender: Female, Male. Age: 18-64 years. Enrolment: 72.
Status: Ended. Start date (EU): 2024-01-08. End date (EU): 2024-10-10. Decision date: 2023-12-19. Results received: No. Last updated: 2024-06-27.

Condition(s): Neurodevelopmental disorder

Source: https://euclinicaltrials.eu/ctis-public/view/2023-507454-33-00